EU clinical trial 2024-516956-16-01: A phase 2 trial of capecitabine for recurrent and/or metastatic salivary duct carcinoma – CAESAR trial
Protocol code: 116162
Sponsor: Stichting Radboud universitair medisch centrum (Hospital/Clinic/Other health care facility). Phase: Phase II and Phase III (Integrated). Countries: Netherlands (authorised, recruitment pending).
Therapeutic area(s): Diseases [C] - Neoplasms [C04]
Gender: Female, Male. Age: 18-64 years, 65+ years. Enrolment: 17.
Status: Authorised, recruitment pending. Decision date: 2025-03-10. Results received: No. Last updated: 2025-03-10.

Condition(s): Salivary Duct Carcinoma
Product: CAPECITABINE

Primary endpoint: Best Overall Respone Rate
Endpoint(s): Progression-free survival, Overall survival, Clinical benefit rate, Disease control rate, Safety, Quality of life

Source: https://euclinicaltrials.eu/ctis-public/view/2024-516956-16-01